EU clinical trial 2022-501895-25-00: A randomized, parallel-group, double-blind, placebo-controlled, multicenter Phase III trial to evaluate efficacy and safety of secukinumab administered subcutaneously versus placebo, in combination with a glucocorticoid taper regimen, in patients with polymyalgia rheumatica (PMR)
Protocol code: CAIN457C22301
Sponsor: Novartis Pharma AG (Pharmaceutical company). Phase: Therapeutic confirmatory (Phase III). Countries: Denmark (ended), Italy (ended), France (ended), Germany (ended), Netherlands (ended), Hungary (ended), Spain (ended), Czechia (ended), Poland (ended), Belgium (ended), Finland (ended), Iceland (ended), Ireland (ended), Sweden (ended), Norway (ended).
Therapeutic area(s): Diseases [C] - Musculoskeletal Diseases [C05]
Gender: Female, Male. Age: 18-64 years, 65+ years. Enrolment: 233.
Status: Ended. Start date (EU): 2023-09-13. End date (EU): 2026-02-16. End date: 2026-02-17. Decision date: 2023-06-13. Results received: No. Last updated: 2026-01-19.
Decision dates by country: FI: 2024-05-20, NO: 2024-05-21, SE: 2024-05-02, IE: 2024-05-24, IS: 2024-05-21, BE: 2023-09-11, PL: 2023-06-19, ES: 2023-07-25, HU: 2023-06-16, DE: 2023-06-14, FR: 2023-06-16, CZ: 2023-06-15, NL: 2023-07-21, DK: 2023-06-13, IT: 2023-06-14

Condition(s): Polymyalgia Rheumatica
Product: Placebo to AIN457 150 mg/1 mL Solution for injection in pre-filled syringe, PREDNISONE, SECUKINUMAB, PREDNISONE, PREDNISONE

Primary endpoint: Proportion of participants achieving sustained remission at Week 52
Endpoint(s): Proportion of participants achieving complete sustained remission at Week 52, Proportion of participants achieving sustained remission at Week 52, Proportion of participants achieving complete sustained remission at Week 52, Adjusted annual cumulative GC dose through Week 52 adjusted by duration of study follow-up, Time to first use of escape treatment or rescue treatment as measured in days through Week 52, Adjusted annual cumulative GC dose through Week 52 adjusted by duration of study follow-up, Time to first use of escape treatment or rescue treatment as measured in days through Week 52, Change from BSL FACIT-Fatigue score at Week 52, Change from BSL HAQ-DI score at Week 52, Change from BSL FACIT-Fatigue score at Week 52, Change from BSL HAQ-DI score at Week 52, Safety and tolerability demonstrated by assessing: - All adverse events (AEs) and all serious adverse events (SAEs) (incidence, severity, and relationship to study drug) - Clinically significant changes in clinical laboratory measures and vital signs, AEs that are related to GC use by investigator judgement

Source: https://euclinicaltrials.eu/ctis-public/view/2022-501895-25-00